EU clinical trial 2024-512407-39-00: Beta-blockeRs tO patieNts with CHronIc Obstructive puLmonary diseasE (BRONCHIOLE)
Protocol code: BRONCHIOLE-2017
Sponsor: Region Oerebro Laen (Hospital/Clinic/Other health care facility). Phase: Therapeutic use (Phase IV). Countries: Sweden (ended).
Therapeutic area(s): Diseases [C] - Respiratory Tract Diseases [C08]
Gender: Female, Male. Age: 18-64 years, 65+ years. Enrolment: 1700.
Status: Ended. End date (EU): 2025-11-19. Decision date: 2024-07-09. Results received: No. Last updated: 2025-05-07.

Condition(s): Chronic obstructive pulmonary disease
Product: Seloken 100mg tablett, Seloken 50 mg tablett

Primary endpoint: A composite of time to death, exacerbations of COPD, and cardiovascular events (myocardial infarction, angina pectoris, heart failure, stroke, transient ischemic attack, or cerebral hemorrhage) recorded in the Swedish National Patient Register or in electronic primary care records (ICD codes I20, I21,122, I48, I50.1-9, I61, I63 or G45.9)
Endpoint(s): Time to death (all-cause and cause-specific), Time to exacerbation of COPD, Time to a cardiovascular event, Extensive health-economic analysis

Source: https://euclinicaltrials.eu/ctis-public/view/2024-512407-39-00